EU clinical trial 2023-508278-26-01: A phase I clinical trial on combined (neo-)adjuvant intravenous plus intracranial administration of ipilimumab and nivolumab in recurrent glioblastoma.
Sponsor: UZ Brussel (Hospital/Clinic/Other health care facility). Phase: Phase I and Phase II (Integrated)- First administration to humans. Countries: Belgium (ongoing, recruitment ended).
Therapeutic area(s): Diseases [C] - Neoplasms [C04]
Gender: Female, Male. Age: 18-64 years, 65+ years. Enrolment: 18.
Status: Ongoing, recruitment ended. Start date (EU): 2024-04-05. Decision date: 2024-03-18. Results received: No. Last updated: 2025-06-03.

Condition(s): glioblastoma

Source: https://euclinicaltrials.eu/ctis-public/view/2023-508278-26-01